EU clinical trial 2024-511853-23-00: A phase 1/2a study to evaluate the dose, safety, tolerability, and efficacy of an intraperitoneal α-emitting radionuclide therapy (Radspherin®) in subjects with peritoneal carcinomatosis from colorectal carcinoma following hyperthermic intraperitoneal chemotherapy
Sponsor: Oncoinvent ASA (Pharmaceutical company). Phase: Human Pharmacology (Phase I)- First administration to humans. Countries: Sweden (ended), Norway (ended).
Therapeutic area(s): Diseases [C] - Neoplasms [C04]
Gender: Female, Male. Age: 18-64 years, 65+ years. Enrolment: 54.
Status: Ended. Start date (EU): 2020-05-12. End date (EU): 2025-04-23. Decision date: 2024-09-23. Results received: No. Last updated: 2025-05-09.
Decision dates by country: SE: 2024-09-23, NO: 2024-09-27

Condition(s): Peritoneal carcinomatosis (PC) from colorectal carcinoma

Source: https://euclinicaltrials.eu/ctis-public/view/2024-511853-23-00